EU clinical trial 2023-507351-29-00: A 52-Week, Open-Label Extension Study of ACP-204 in Adults with Alzheimer's Disease Psychosis
Protocol code: ACP-204-008
Sponsor: Acadia Pharmaceuticals Inc. (Pharmaceutical company). Phase: Therapeutic confirmatory (Phase III). Countries: Spain (ongoing, recruiting), Bulgaria (ongoing, recruiting), France (ongoing, recruiting), Italy (ongoing, recruiting), Czechia (ongoing, recruiting).
Therapeutic area(s): Diseases [C] - Nervous System Diseases [C10]
Gender: Female, Male. Age: 18-64 years, 65+ years. Enrolment: 196.
Status: Ongoing, recruiting. Start date (EU): 2024-12-03. Decision date: 2024-05-31. Results received: No. Last updated: 2026-05-14.
Decision dates by country: CZ: 2024-06-03, ES: 2024-05-31, BG: 2024-06-04, IT: 2024-05-31, FR: 2024-06-03

Condition(s): Alzheimer's Disease Psychosis

Primary endpoint: Treatment-emergent adverse events [Time Frame: 52 Weeks] Number of Subjects With Adverse Events (AEs), Discontinuations Due to AEs and Serious AEs (SAEs) over 52 weeks of treatment. The Safety population consists of all subjects who received at least one dose of study drug in this study.
Endpoint(s): Clinical Global Impression-Improvement in the ADP context (CGI-I-ADP) score [Time Frame: 52 Weeks]

Source: https://euclinicaltrials.eu/ctis-public/view/2023-507351-29-00